EU clinical trial 2022-502807-31-00: Exploratory pilot study to determine the tolerability and effectiveness of Tirbanibulin in the treatment of Actinic Cheilitis
Protocol code: TUD-AKTCHE-082
Sponsor: Technische Universitat Dresden (Educational Institution). Phase: Therapeutic exploratory (Phase II). Countries: Germany (ended).
Therapeutic area(s): Diseases [C] - Skin and Connective Tissue Diseases [C17]
Gender: Female, Male. Age: 18-64 years, 65+ years. Enrolment: 20.
Status: Ended. Start date (EU): 2023-09-26. End date (EU): 2024-11-14. Decision date: 2023-07-17. Results received: Yes. Last updated: 2023-07-17.

Condition(s): Actinic Cheilitis
Product: Klisyri 10 mg/g ointment

Primary endpoint: Complete recovery rate (healing) of Actinic Cheilitis, 8 weeks after the application of Tirbanibulin for 5 days (visit 4, day 56). Complete recovery is defined as an affected area of 0 cm.
Endpoint(s): Reduction of the affected area by means of the size of the affected lip area in cm² and the reduction of the affected area in % at day 56 compared to baseline (area in cm² at baseline, area in cm² at day 56, reduction of the area in %), Study subject self-assessment (individual and total scores according to the visit schedule as well as the difference of the scores compared to baseline), Local skin reaction score (individual and total scores as per visit schedule as well as the difference of the scores compared to baseline, Oral Health DLQI-Score (individual and total scores as per visit as well as the difference of the scores compared to baseline), Frequency of AEs and SAEs during the duration of the trial (visit 4), Discrepancies in diagnosing Actinic Cheilitis by means of optical coherence tomography, confocal laser scanning microscopy, line-field confocal optical coherence tomography, diagnostic confidence, imaging quality at baseline compared to the final visit.

Source: https://euclinicaltrials.eu/ctis-public/view/2022-502807-31-00